EU clinical trial 2025-520730-28-00: A Phase 2b, Open-Label, Two-cohort Study of Subcutaneous Amivantamab in Combination with Lazertinib as First-Line Treatment, or Subcutaneous Amivantamab in Combination with Platinum-Based Chemotherapy as Second-line Treatment, for Common EGFR-Mutated Locally Advanced or Metastatic Non-Small Cell Lung Cancer
Protocol code: 61186372NSC2012
Sponsor: Janssen Cilag International (Pharmaceutical company). Phase: Therapeutic exploratory (Phase II). Countries: Germany (ongoing, recruiting), Spain (ongoing, recruiting), Finland (ongoing, recruiting), Greece (ongoing, recruiting), Portugal (ongoing, recruiting), Italy (ongoing, recruiting), Belgium (ongoing, recruiting), Poland (ongoing, recruiting), France (ongoing, recruiting).
Therapeutic area(s): Diseases [C] - Neoplasms [C04]
Gender: Female, Male. Age: 18-64 years, 65+ years. Enrolment: 118.
Status: Ongoing, recruiting. Start date (EU): 2025-12-08. Decision date: 2025-11-27. Results received: No. Last updated: 2026-05-20.
Decision dates by country: FR: 2025-12-02, GR: 2025-12-02, IT: 2025-11-28, PT: 2025-12-03, ES: 2025-11-28, PL: 2025-11-30, FI: 2025-11-28, BE: 2025-12-23, DE: 2025-11-28

Condition(s): Common EGFR-Mutated Locally Advanced or Metastatic Non-Small Cell Lung Cancer
Product: JNJ-73841937, JNJ-61186372

Primary endpoint: PFS according to RECIST v1.1 by investigator assessment

Source: https://euclinicaltrials.eu/ctis-public/view/2025-520730-28-00